EU clinical trial 2025-522288-13-00: ETOP 29-25 START-lung: A multicentre phase II trial of tarlatamab in patients with pretreated extensive-stage small cell lung cancer (ES-SCLC) and ECOG PS 2.
Protocol code: ETOP29-25 START-lung
Sponsor: ETOP IBCSG Partners Foundation (Laboratory/Research/Testing facility). Phase: Therapeutic exploratory (Phase II). Countries: France (authorised, recruiting), Greece (ongoing, recruiting), Spain (ongoing, recruiting), Italy (ongoing, recruiting).
Therapeutic area(s): Diseases [C] - Neoplasms [C04]; Diseases [C] - Respiratory Tract Diseases [C08]
Gender: Female, Male. Age: 18-64 years, 65+ years. Enrolment: 40.
Start date (EU): 2026-05-21. Decision date: 2026-04-08. Results received: No. Last updated: 2026-07-20.
Decision dates by country: GR: 2026-04-08, ES: 2026-04-15, IT: 2026-04-20, FR: 2026-04-13

Condition(s): Patients with pretreated extensive-stage small cell lung cancer (ES-SCLC) and ECOG PS 2
Product: Tarlatamab, Tarlatamab

Primary endpoint: Overall survival rate at 12 months (12-month OS)
Endpoint(s): Objective response rate (ORR) according to RECIST v1.1, Duration of response (DoR), Disease control rate (DCR), Progression-free survival (PFS) according to RECIST v1.1, Incidence, nature, and severity of adverse events according to CTCAE v5, except for CRS and ICANS, that are graded according to the ASTCT criteria and TLS that are graded according to the Cairo-Bishop classification

Source: https://euclinicaltrials.eu/ctis-public/view/2025-522288-13-00